EU clinical trial 2023-507385-11-00: Long-Term Follow-Up of Subjects Treated With NTLA-2001
Protocol code: ITL-2001-CL-999
Sponsor: Intellia Therapeutics Inc. (Pharmaceutical company). Phase: Phase II and Phase III (Integrated). Countries: Sweden (ongoing, recruiting), France (ongoing, recruiting).
Therapeutic area(s): Diseases [C] - Congenital, Hereditary, and Neonatal Diseases and Abnormalities [C16]
Gender: Female, Male. Age: 18-64 years, 65+ years. Enrolment: 15.
Status: Ongoing, recruiting. Start date (EU): 2024-05-06. Decision date: 2024-04-16. Results received: No. Last updated: 2026-07-10.
Decision dates by country: SE: 2024-04-16, FR: 2024-10-18

Condition(s): -Hereditary Transthyretin Amyloidosis with Polyneuropathy (ATTRv-PN); -Transthyretin Amyloidosis-Related Cardiomyopathy (ATTR-CM)
Product: NTLA-2001

Primary endpoint: For ATTR-CM and ATTRv-PN participants, incidence of: • Treatment-related SAEs • Protocol-specified AESIs
Endpoint(s): PD biomarkers for ATTR over time: • Serum TTR • Serum prealbumin

Source: https://euclinicaltrials.eu/ctis-public/view/2023-507385-11-00